EU clinical trial 2025-521620-29-01: Efficacy and safety of two moisturising creams for maintenance treatment of atopic dermatitis compared to no treatment: A prospective, controlled, split-body study
Protocol code: GAL-005
Sponsor: Galenica AB (Pharmaceutical company). Phase: Therapeutic exploratory (Phase II). Countries: Norway (ongoing, recruiting), Sweden (ongoing, recruiting).
Therapeutic area(s): Diseases [C] - Skin and Connective Tissue Diseases [C17]
Gender: Female, Male. Age: 18-64 years, 65+ years. Enrolment: 78.
Status: Ongoing, recruiting. Start date (EU): 2026-01-26. Decision date: 2025-11-24. Results received: No. Last updated: 2026-06-09.
Decision dates by country: NO: 2025-11-25, SE: 2025-11-24

Condition(s): Atopic Dermatitis
Product: Urea/propylene glycol 50 mg/g + 250 mg/g cream, Oviderm 250 mg/g kräm

Primary endpoint: • Time to relapse of eczema (patient reported outcome [PRO]) on a defined study area from baseline until the eczema relapses or until the end of the maintenance phase, whichever comes first
Endpoint(s): • Time to relapse of eczema (PRO) on a defined study area from baseline until the eczema relapses or until the end of the maintenance phase, whichever comes first, • Change in self-reported pruritus on defined study area from baseline until the eczema relapses or until the end of the maintenance phase, whichever comes first, using Peak Pruritus Numerical Rating Scale (NRS), • Change in self-reported pruritus on defined study area from baseline until the eczema relapses or until the end of the maintenance phase, whichever comes first, using Peak Pruritus Numerical Rating Scale (NRS) per time, • Frequency of adverse events during the maintenance phase

Source: https://euclinicaltrials.eu/ctis-public/view/2025-521620-29-01